EU clinical trial 2022-501526-38-00: Long-Term Follow-Up (LTFU) for Gene Therapy of Pyruvate Kinase Deficiency (PKD): A Phase I Clinical Trial to Evaluate the Safety of the Infusion of Autologous CD34+ Cells Transduced with a Lentiviral Vector Carrying the Codon Optimized Red Cell Pyruvate Kinase (coRPK) Gene in Adult and Pediatric Subjects with PKD
Protocol code: RP-L301-0222-LTFU
Sponsor: Rocket Pharmaceuticals Inc. (Pharmaceutical company). Phase: Human Pharmacology (Phase I)- Other. Countries: Spain (ongoing, recruitment ended).
Therapeutic area(s): Diseases [C] - Hemic and Lymphatic Diseases [C15]
Gender: Female, Male. Age: 0-17 years, 18-64 years. Enrolment: 4.
Status: Ongoing, recruitment ended. Start date (EU): 2023-06-06. Decision date: 2023-01-09. Results received: No. Last updated: 2025-04-22.

Condition(s): Pyruvate kinase deficiency
Product: Merilen

Primary endpoint: Overall survival, Peripheral blood genetic correction, as demonstrated by vector copy number (VCN), Any red blood cell transfusion, Sustained and significant decrease in hemoglobin unrelated to infection or surgery, Adverse events related to worsening iron overload (for example, cirrhosis, cardiomyopathy, etc.), Any adverse event considered at least possibly related to RP-L301, Development of any malignancy

Source: https://euclinicaltrials.eu/ctis-public/view/2022-501526-38-00